EU clinical trial 2025-522782-30-00: A study to learn if bimekizumab given in different ways is safe and moves similarly throughout the body over time in adults
Protocol code: PA0019
Sponsor: UCB Biopharma (Pharmaceutical company). Phase: Human Pharmacology (Phase I)- Other. Countries: Croatia (authorised, recruitment pending), Poland (ongoing, recruiting), Germany (ongoing, recruiting), Czechia (ongoing, recruiting), Slovakia (authorised, recruitment pending), Bulgaria (ongoing, recruiting).
Therapeutic area(s): Diseases [C] - Immune System Diseases [C20]
Gender: Female, Male. Age: 18-64 years, 65+ years. Enrolment: 293.
Start date (EU): 2026-04-07. Decision date: 2026-03-16. Results received: No. Last updated: 2026-07-24.
Decision dates by country: BG: 2026-03-23, SK: 2026-03-16, HR: 2026-03-23, CZ: 2026-06-12, PL: 2026-03-23, DE: 2026-03-17

Condition(s): CCI

Source: https://euclinicaltrials.eu/ctis-public/view/2025-522782-30-00